EU clinical trial 2025-523101-15-00: First-in-human (FIH) Trial of GEN3018 in Relapsed or Refractory (R/R) Acute Myeloid Leukemia (AML) or Higher-risk Myelodysplastic Syndrome (HR-MDS)
Protocol code: GCT3018-01
Sponsor: Genmab A/S (Pharmaceutical company). Phase: Human Pharmacology (Phase I)- First administration to humans. Countries: Denmark (ongoing, recruiting), Spain (ongoing, recruiting).
Therapeutic area(s): Diseases [C] - Neoplasms [C04]
Gender: Female, Male. Age: 18-64 years, 65+ years. Enrolment: 40.
Status: Ongoing, recruiting. Start date (EU): 2026-02-16. Decision date: 2026-01-16. Results received: No. Last updated: 2026-03-11.
Decision dates by country: DK: 2026-01-16, ES: 2026-03-11

Condition(s): Relapsed or Refractory Acute Myeloid Leukemia or Higher-Risk Myelodysplastic Syndrome

Source: https://euclinicaltrials.eu/ctis-public/view/2025-523101-15-00